EU clinical trial 2023-509841-12-00: A single-dose, randomized, two-period, two-sequence, crossover pilot bioequivalence study on formulations containing rivaroxaban and acetylsalicylic acid in healthy volunteers under fasting conditions.
Protocol code: 01/2023/Pozlab
Sponsor: Cepha s.r.o., Pozlab Sp. z o.o. (Pharmaceutical company). Phase: Human Pharmacology (Phase I)- Bioequivalence Study. Countries: Czechia (ended).
Therapeutic area(s): Diseases [C] - Cardiovascular Diseases [C14]
Gender: Female, Male. Age: 18-64 years. Enrolment: 14.
Status: Ended. Start date (EU): 2024-02-28. End date (EU): 2024-03-18. Decision date: 2024-02-05. Results received: No. Last updated: 2024-02-05.

Condition(s): increased blood clotting

Source: https://euclinicaltrials.eu/ctis-public/view/2023-509841-12-00